EU clinical trial 2024-515186-33-00: Saracatinib trial TO Prevent FOP (STOPFOP)
Protocol code: STOPFOP1
Sponsor: Stichting Amsterdam UMC (Hospital/Clinic/Other health care facility). Phase: Therapeutic exploratory (Phase II). Countries: Germany (ongoing, recruitment ended), Netherlands (ongoing, recruitment ended).
Therapeutic area(s): Diseases [C] - Musculoskeletal Diseases [C05]
Gender: Female, Male. Age: 18-64 years. Enrolment: 18.
Status: Ongoing, recruitment ended. Start date (EU): 2020-01-08. Decision date: 2025-01-17. Results received: No. Last updated: 2026-08-05.
Decision dates by country: NL: 2025-01-17, DE: 2025-01-22

Condition(s): Fibrodyplasia Ossificans Progressiva (FOP)
Product: AZD0530, placebo, film-coated tablets, AZD0530, Saracatinib

Primary endpoint: Primary Safety: Incidence and severity of treatment- emergent adverse events through the end of the Treatment Period 1 at week 26 (RCT). Primary Efficacy: Number of new lesions in the RCT defined as: Number of individual new active HO lesions assessed by [18F]-NaF PET at week 26 in placebo vs. drug arms of the RCT; and number of individual new HO lesions detected by CT at week 26 in placebo vs. drug arms of the RCT
Endpoint(s): 1. The incidence and severity of adverse events (AE) a. During the 6-month RCT b. During 6-month open label extension of AZD0530, 2. Number of new lesions after one year of cross-over therapy, defined as: Number of individual new active HO lesions assessed by [18F]-NaF PET between the placebo arm at week 26 and the subsequent open-label phase at week 52 among pa-tients receiving placebo during the RCT; Number of individual new HO lesions detected by CT be-tween the placebo arm at week 26 and the subsequent open-label arm at week 52 among patients receiving placebo during the RCT, 3. Difference in [18F] NaF PET activity of individual active lesion(s) by PET at week 26 between the placebo and drug arms of the RCT, or between the placebo arm at week 26 and its subsequent open label arm at week 52 among cross-over patients., 4. Difference in volume of individual active lesions as assessed by [18F] NaF PET at week 26 between the placebo and drug arm of the RCT, or between the placebo arm at week 26 and its subsequent open label arm at week 52 among cross-over patients., 5. Change in volume of individual HO lesions as assessed by by CT at week 26 between the placebo and drug arm of the RCT, or between the placebo arm at week 26 and its subsequent open label arm at week 52 among cross-over patients., 6. Change in functional mobility outcomes from baseline to week 26 between the place-bo versus drug arm of the RCT, or change between baseline and week 26 in the pla-cebo arm versus the change between week 26 and week 52 among cross-over pa-tients initially treated with placebo in the RCT, as assessed by:, 6. (Continued) a. Change in the cumulative analogue joint involvement scale for FOP (CAJIS); b. Change in the quantitative detailed multi-joint assessment by goniometry, c. Change in interincisal distance (mouth opening, mm.) d. Change in forced vital capacity (FVC) as percent of predicted based on age, sex, and body mass index., 7. Change in functional mobility outcomes at week 52, 104, and week 156 of drug treat-ment compared to baseline measurements, in reference to Ipsen natural history data (NCT02322255) and/or other history data on rate of progression of these measure-ments in an untreated FOP population where available., 7. (Continued) a. Change in the cumulative analogue joint involvement scale for FOP (CAJIS); b. Change in the quantitative detailed multi-joint assessment by goniometry; c. Change in interincisal distance (mouth opening, mm.); d. Change in forced vital capacity (FVC) as percent of predicted based on age, sex, and body mass index.

Source: https://euclinicaltrials.eu/ctis-public/view/2024-515186-33-00